EU clinical trial 2022-502482-17-00: A Phase III, Randomized, Double-Blinded, Placebo-Controlled Study of Tiragolumab, an Anti-Tigit Antibody, in Combination with Atezolizumab Compared with Placebo in Combination with Atezolizumab in Patients With Previously Untreated Locally Advanced Unresectable or Metastatic PD-L1-Selected Non-Small Cell Lung Cancer
Protocol code: GO41717
Sponsor: F. Hoffmann-La Roche AG (Pharmaceutical company). Phase: Therapeutic confirmatory (Phase III). Countries: Germany (ended), Hungary (ended), Italy (ended), Poland (ended), Spain (ended), Netherlands (ended), Austria (ended), Greece (ended).
Therapeutic area(s): Diseases [C] - Neoplasms [C04]
Gender: Female, Male. Age: 18-64 years, 65+ years. Enrolment: 192.
Status: Ended. Start date (EU): 2020-05-19. End date (EU): 2025-11-05. End date: 2025-12-30. Decision date: 2024-08-19. Results received: Yes. Last updated: 2025-08-11.
Decision dates by country: GR: 2024-11-05, HU: 2024-08-27, IT: 2024-09-02, NL: 2024-08-19, PL: 2024-08-30, DE: 2024-08-26, ES: 2024-08-26, AT: 2024-08-26

Condition(s): Non-small cell lung cancer (NSCLC)
Product: Tiragolumab, Placebo Tiragolumab, Tecentriq 1 200 mg concentrate for solution for infusion

Primary endpoint: 1. PFS as determined by the investigator according to RECIST v1.1 in the primary analysis population, 2. Overall Survival (OS) in the primary analysis population
Endpoint(s): 1. Investigator assessed PFS according to RECIST v1.1 in the secondary analysis population, 2. OS in the secondary analysis population, 3. Confirmed ORR as determined by the investigator according to RECIST v1.1, 4. DOR for patients with confirmed ORR as determined by the investigator according to RECIST v1.1, 5. PFS rate at 6 months and 12 months as determined by the investigator according to RECIST v1.1, 6. OS rate at 12 months and 24 months, 7. Time to confirmed deterioration (TTCD) in patient-reported physical functioning and global health status/quality of life, as measured by the European Organisation for Research and Treatment of Cancer Quality of Life Questionnaire for Cancer, 8. Incidence and severity of adverse events, with severity determined according to the National Cancer Institute Common Terminology Criteria for Adverse Events, Version 5.0, 9. Severity for CRS will also be determined according to the ASTCT CRS consensus grading scale, 10. Serum concentrations of tiragolumab and atezolizumab at specified timepoints, 11. Prevalence of ADAs to tiragolumab at baseline and incidence of ADAs to tiragolumab during the study, 12. Prevalence of ADAs to atezolizumab at baseline and incidence of ADAs to atezolizumab during the study, 13. Change in EQ-5D-5L index-based and visual analog scale (VAS) scores at specified timepoints during the study (including post-progression)

Source: https://euclinicaltrials.eu/ctis-public/view/2022-502482-17-00